EU clinical trial 2025-523939-18-00: A Phase 1b/2 Study to Evaluate NB-4746 in Participants with Amyotrophic Lateral Sclerosis.
Protocol code: NB-4746-201
Sponsor: Nura Bio Inc. (Pharmaceutical company). Phase: Phase I and Phase II (Integrated)- Other. Countries: Poland (ongoing, recruiting), Netherlands (ongoing, recruiting), Italy (authorised, recruitment pending), Spain (authorised, recruitment pending).
Therapeutic area(s): Diseases [C] - Nervous System Diseases [C10]
Gender: Female, Male. Age: 18-64 years, 65+ years. Enrolment: 46.
Start date (EU): 2026-06-23. Decision date: 2026-06-03. Results received: No. Last updated: 2026-07-09.
Decision dates by country: IT: 2026-06-03, NL: 2026-06-03, ES: 2026-06-04, PL: 2026-06-05

Condition(s): Amyotrofic Lateral Sclerosis (ALS)
Product: Riluzole, NB-4746, NB-4746, Riluzole, Placebo capsules for NB 4746

Primary endpoint: Phase Ib: Number of treatment emergent adverse events (TEAEs) and number of serious adverse events (SAEs)., Phase II: TEAEs, and changes in vital signs, clinical laboratory tests, and 12-lead ECGs., Open label Extention: TEAEs, and changes in vital signs, clinical laboratory tests, and 12-lead ECGs.

Source: https://euclinicaltrials.eu/ctis-public/view/2025-523939-18-00